EU clinical trial 2024-510968-22-00: A Proof of Concept, Multicentre, Phase 2, Double- Blind, Randomized, Placebo-Controlled Study on the Efficacy, Safety and Tolerability of d-Methadone in Moderate to Very Severe Restless Legs Syndrome with Periodic Limb Movements: the Glu-REST Study
Protocol code: NSI-RLS-001
Sponsor: Ente Ospedaliero Cantonale (EOC) (Hospital/Clinic/Other health care facility). Phase: Therapeutic exploratory (Phase II). Countries: Italy (temporarily halted).
Therapeutic area(s): Diseases [C] - Nervous System Diseases [C10]
Gender: Female, Male. Age: 18-64 years, 65+ years. Enrolment: 12.
Status: Temporarily halted. Start date (EU): 2024-03-12. Decision date: 2024-02-28. Results received: No. Last updated: 2025-01-24.

Condition(s): restless leg syndrome
Product: exact match to the active tablets in size, color and marking without the active ingredient d-methadone HCl

Primary endpoint: The percentage of responders to REL-1017 treatment. A responder is defined as a patient with ≥ 50% reduction in the International RLS Rating Scale (IRLS-RS) score from baseline (Day 1) to end of the treatment period (Day 30) with assessments performed on Day 1, Day 31 and Day 37.
Endpoint(s): Change in RLS symptoms and severity from baseline (Day 1) to the end of 10-day dosing period and to end of the treatment period (Day 30) as measured by the IRLS-RS score with assessments performed on Day 1, Day 11, Day 31 and Day 37., Change from baseline (Day 1) to the end of 10-day dosing period and to end of the treatment period (Day 30) on Total Sleep Time (TST), Sleep Latency (SL) and Sleep Efficacy (SE) acquired by actigraphy with measurements performed prior to the start of treatment (from Day -7 to Day -1), during the 10-day dosing period (from Day 1 to Day 11) and at the end of the treatment (from Day 24 to Day 31), Percentage of responders to 10-day dosing with REL-1017. A responder is defined as a patient with ≥ 50% reduction in the IRLS-RS score from baseline (Day 1) to end of 10-day dosing period with assessments performed on Day 1 and Day 11., Change from baseline (Day 1) to end of 10-day dosing period on PLMS index with measurements performed on Day 1 and Day 11, Change from baseline (Day 1) to end of 10-day dosing period on TST, SL and SE, number of awakenings, arousal index, recorded by PSG with measurements performed on Day 1 and Day 11.

Source: https://euclinicaltrials.eu/ctis-public/view/2024-510968-22-00